EU clinical trial 2024-516787-28-00: EPITOME-1015-I: A phase I study to investigate the safety and tolerability of MDG1015 in patients with epithelial ovarian cancer, gastroesophageal adenocarcinoma, round cell liposarcoma and/or synovial sarcoma
Protocol code: CD-TCR-004
Sponsor: Medigene AG (Pharmaceutical company). Phase: Human Pharmacology (Phase I)- First administration to humans. Countries: Netherlands (authorised, recruitment pending).
Therapeutic area(s): Diseases [C] - Neoplasms [C04]
Gender: Female, Male. Age: 18-64 years, 65+ years. Enrolment: 20.
Status: Authorised, recruitment pending. Decision date: 2025-04-01. Results received: No. Last updated: 2025-04-01.

Condition(s): Epithelial Ovarian Carcinoma, Myxoid (Round Cell) Liposarcoma, Gastroesophageal (Junction) Adenocarcinoma, Synovial Sarcoma

Source: https://euclinicaltrials.eu/ctis-public/view/2024-516787-28-00